EU clinical trial 2023-508662-15-00: RIVKAL clinical trial for the first-in-human administration of BIM2b in participants with Glioblastoma
Protocol code: 2024-BI-01 (RIVKAL)
Sponsor: Beta Innov (Pharmaceutical company). Phase: Human Pharmacology (Phase I)- First administration to humans. Countries: France (authorised, recruitment pending).
Therapeutic area(s): Diseases [C] - Neoplasms [C04]
Gender: Female, Male. Age: 18-64 years, 65+ years. Enrolment: 36.
Status: Authorised, recruitment pending. Decision date: 2024-10-09. Results received: No. Last updated: 2026-07-21.

Condition(s): Glioblastoma

Source: https://euclinicaltrials.eu/ctis-public/view/2023-508662-15-00